EU clinical trial 2023-504644-34-00: Phase 3 confirmatory, randomised 1:1 double-blind, placebo-controlled study evaluating the analgesic efficacy of capsaicin 8% patches in chronic coccygodynia. CAPSACOX Study.
Protocol code: RC22_0415
Sponsor: Centre Hospitalier Universitaire De Nantes (Hospital/Clinic/Other health care facility). Phase: Therapeutic confirmatory (Phase III). Countries: France (ongoing, recruiting).
Therapeutic area(s): Diseases [C] - Pathological Conditions, Signs and Symptoms [C23]
Gender: Female, Male. Age: 18-64 years, 65+ years. Enrolment: 188.
Status: Ongoing, recruiting. Start date (EU): 2023-11-08. Decision date: 2023-08-08. Results received: No. Last updated: 2024-07-25.

Condition(s): Subject with chronic coccygodynia

Source: https://euclinicaltrials.eu/ctis-public/view/2023-504644-34-00